EU clinical trial 2025-523207-29-00: Evaluation of postoperative recovery when combining intravenous lidocaine with ropivacaine infiltration in laparoscopic colorectal oncologic surgery: a randomized controlled trial
Protocol code: PI2025_843_0004
Sponsor: Centre Hospitalier Universitaire Amiens Picardie (Hospital/Clinic/Other health care facility). Phase: Therapeutic use (Phase IV). Countries: France (ongoing, recruiting).
Therapeutic area(s): Not possible to specify
Gender: Female, Male. Age: 18-64 years, 65+ years. Enrolment: 182.
Status: Ongoing, recruiting. Start date (EU): 2026-04-24. Decision date: 2025-12-17. Results received: No. Last updated: 2025-12-17.

Condition(s): colorectal cancer laparoscopic surgery
Product: ACUPAN, solution injectable, XYLOCARD 20 mg/ml INTRAVEINEUX, solution injectable, DEXAMETHASONE KRKA 8 mg/2 ml, solution injectable/pour perfusion, NEFOPAM BIOGARAN 20 mg/2 mL, solution injectable, Paracetamol 10 mg/ml Solution for Infusion, SUFENTANIL KALCEKS 5 microgrammes/mL, solution injectable/pour perfusion, Parecoxib Seacross 40 mg powder for solution for injection, CELEBREX 100 mg capsule, ACTISKENAN 5 mg, gélule, Propofol Kabi 10 mg/ml emulsion for injection or infusion, KETAMINE G.L. PHARMA 10 mg/mL, solution injectable, ROPIVACAINE B.BRAUN 2 mg/ml, solution injectable/pour perfusion

Primary endpoint: Postoperative recovery assessed using the QOR-15 scale twenty-four hours after surgery.
Endpoint(s): Assessment of plasma concentrations of lidocaine (toxic threshold >5 µg/mL) and ropivacaine (toxic threshold >2.2 µg/mL), Signs of local anesthetic toxicity sought in the post-anesthesia care unit (PACU) for up to two hours after the end of the procedure: o Cardiological (conduction disorders, atrioventricular conduction disorders, rhythm disorders, especially ventricular: ventricular tachycardia, ventricular fibrillation, or even cardiac arrest in asystole) o Neurological (perioral tingling, headaches, visual or auditory distortions, tremors in the extremities, loss of consciousness, coma, convulsions), Postoperative pain assessed using the numerical rating scale (NRS) at H2 at rest, H24 at rest and during mobilization, H48 at rest and during mobilization, Maximum pain assessed using the NRS during the first 48 hours, Postoperative analgesic consumption during the first 48 hours, Consumption of morphine derivatives expressed in oral morphine equivalent (mg) per operation and 48 hours post-operatively, Occurrence of dysesthesia (peri-scar hyperalgesia, allodynia, numbness) at the surgical site at 48 hours, Neuropathic pain, defined as a DN4 score > 4/10 at 48 hours and 3 months, The time before resumption of transit (resumption of gas and then bowel movements) and food tolerance will be assessed through daily interviews with the physician., Medical and surgical complications will be assessed using the Clavien Dindo score one month after surgery., Possibility of chemotherapy within two months post-op if indicated by the oncology multidisciplinary team meeting, Length of stay from admission to discharge, expressed in days, Patient satisfaction, assessed using the EVANS score upon discharge

Source: https://euclinicaltrials.eu/ctis-public/view/2025-523207-29-00